EU clinical trial 2023-504415-33-00: TRAUMACELL - Effects of intravascular administration of mesenchymal stromal cells derived from Wharton’s Jelly of the umbilical cord on systemic immunomodulation and neuroinflammation after traumatic brain injury.
Protocol code: APHP211509
Sponsor: Assistance Publique Hopitaux De Paris (Hospital/Clinic/Other health care facility). Phase: Phase I and Phase II (Integrated)- Other. Countries: France (ongoing, recruiting).
Therapeutic area(s): Diseases [C] - Nervous System Diseases [C10]
Gender: Female, Male. Age: 18-64 years. Enrolment: 88.
Status: Ongoing, recruiting. Start date (EU): 2024-06-25. Decision date: 2023-10-13. Results received: No. Last updated: 2026-05-29.

Condition(s): Patients aged 15 years and 3 months and older with severe head trauma

Source: https://euclinicaltrials.eu/ctis-public/view/2023-504415-33-00